EU clinical trial 2023-506921-12-00: A Randomized, Double-Blind, Phase III Study of Pembrolizumab versus Placebo in Combination with Neoadjuvant Chemotherapy and Adjuvant Endocrine Therapy for the Treatment of High-Risk Early-Stage Estrogen Receptor-Positive, Human Epidermal Growth Factor Receptor 2-Negative (ER+/HER2–) Breast Cancer (KEYNOTE-756)
Protocol code: MK-3475-756
Sponsor: Merck Sharp & Dohme LLC (Pharmaceutical company). Phase: Therapeutic confirmatory (Phase III). Countries: Hungary (ongoing, recruitment ended), Spain (ongoing, recruitment ended), France (ongoing, recruitment ended), Ireland (ongoing, recruitment ended), Portugal (ongoing, recruitment ended), Belgium (ongoing, recruitment ended), Germany (ongoing, recruitment ended), Poland (ongoing, recruitment ended).
Therapeutic area(s): Diseases [C] - Neoplasms [C04]
Gender: Female, Male. Age: 18-64 years, 65+ years. Enrolment: 424.
Status: Ongoing, recruitment ended. Start date (EU): 2018-12-27. Decision date: 2023-11-10. Results received: No. Last updated: 2026-03-16.
Decision dates by country: HU: 2023-11-10, IE: 2023-11-17, PL: 2024-01-16, DE: 2023-12-08, BE: 2023-11-22, PT: 2023-11-13, ES: 2023-11-15, FR: 2023-11-15

Condition(s): ER+/HER2- Breast Cancer
Product: KEYTRUDA 25 mg/mL concentrate for solution for infusion, EPIRUBICIN, PACLITAXEL, Pacebo to Keytruda: Normal saline or dextrose, DOXORUBICIN, CYCLOPHOSPHAMIDE

Primary endpoint: Pathological Complete Response (pCR) Rate Using the Definition of ypT0/Tis ypN0, Event-Free Survival (EFS)
Endpoint(s): Overall Survival (OS), pCR Rate Using the Definition of ypT0ypN0, pCR Rate Using the Definition of ypT0/Tis, pCR Rate Using the Definitions of ypT0/Tis ypN0, ypT0/Tis, and ypT0 ypN0 in Participants With a Combined Positive Score [CPS] ≥1, EFS in Participants with a CPS ≥1, OS in Participants with a CPS ≥1, Number of Participants Experiencing an Adverse Event (AE), Number of Participants Experiencing a Serious Adverse Event (SAE), Number of Participants Experiencing an Immune-related AE (irAE), Number of Study Treatment Discontinuations Due to AEs, Change from Baseline in European Organisation for Research and Treatment of Cancer (EORTC) Quality of Life (QoL) Questionnaire Core 30 (QLQ-C30) Score, Change from Baseline in EORTC Breast Cancer-Specific QoL Questionnaire (QLQ-BR23) Score

Source: https://euclinicaltrials.eu/ctis-public/view/2023-506921-12-00